EU clinical trial 2022-500455-23-00: An interventional efficacy and safety Phase 3 double-blind 2-arm study to investigate IV followed by oral fosmanogepix compared with IV caspofungin followed by oral fluconazole in adult participants with candidemia and/or invasive candidiasis.
Protocol code: FMGX-CS-301
Sponsor: Basilea Pharmaceutica International AG Allschwil (Pharmaceutical company). Phase: Therapeutic confirmatory (Phase III). Countries: Belgium (ongoing, recruiting), Italy (ongoing, recruiting), Germany (ongoing, recruiting), France (ongoing, recruiting), Bulgaria (ongoing, recruiting), Austria (ongoing, recruiting), Greece (ongoing, recruiting), Spain (ongoing, recruiting).
Therapeutic area(s): Diseases [C] - Bacterial Infections and Mycoses [C01]
Gender: Female, Male. Age: 18-64 years, 65+ years. Enrolment: 157.
Status: Ongoing, recruiting. Start date (EU): 2024-12-11. Decision date: 2022-10-26. Results received: No. Last updated: 2026-05-26.
Decision dates by country: ES: 2025-01-31, AT: 2025-01-31, IT: 2022-11-01, DE: 2022-11-09, GR: 2025-01-28, BE: 2022-10-26, FR: 2023-07-07, BG: 2022-10-27

Condition(s): Candidemia, Invasive candidiasis
Product: Placebo for fluconazole capsule 200 mg, oral administration, SODIUM CHLORIDE, Placebo for Fosmanogepix IV and Caspofungin IV, Placebo for fosmanogepix 400 mg tablet, oral administration, Fosmanogepix, CASPOFUNGIN, Fosmanogepix, FLUCONAZOLE

Primary endpoint: Proportion of patients with an overall response of treatment success at end of study treatment (EOST). Time Frame: EOST (up to Day 42)
Endpoint(s): 1. Proportion of patients alive at Day 30. Time Frame: Day 30, 2. Proportion of patients with overall response of treatment success at Day 7. Time Frame: Day 7, 3. Proportion of patients with an overall response of treatment success at Day 14. Time Frame: Day 14, 4. Proportion of patients with an overall response of treatment success at end of IV treatment (EOIV). Time Frame: up to Day 42, 5. Proportion of patients with an overall response of treatment success (sustained) at follow-up 6 weeks after EOST. Time Frame: approximately up to 12,5 weeks, 6. Proportion of patients with clinical response of success at Day 7, Day 14, EOIV, EOST, Follow-up 6- weeks after EOST. Time Frame: Day 14, EOIV (up to Day 42), EOST (up to Day 42), Follow-up 6-weeks after EOST, 7. Proportion of patients with mycological response of eradication or presumed eradication at Day 7, Day 14, EOIV, EOST, Follow-up 6-weeks after EOST. Time Frame: Day 14, EOIV (up to Day 42), EOST (up to Day 42), Follow-up 6-weeks after EOST, 8. Time to first negative blood culture in patients on fosmanogepix compared to caspofungin/fluconazole. Time Frame: Baseline up to follow-up 6-weeks after EOST (approximately up to 12,5 weeks), 9. Incidence of treatment-emergent adverse event (TEAEs), serious adverse events (SAEs), treatment-related adverse events (AEs), adverse events of special interest (AESI)and AEs leading to discontinuation. Time Frame: Screening up to follow-up 6-weeks after EOST (approximately up to 12,5 weeks), 10. Number of patients with clinically significant laboratory abnormalities. Time Frame: Baseline up to follow-up 6-weeks after EOST (approximately up to 12,5 weeks), 11. Number of patients with abnormal neurological examination findings. Time Frame: Baseline up to follow-up 6-weeks after EOST (approximately up to 12,5 weeks), 12. Assessment of 12-lead electrocardiogram (ECGs). Time Frame: Baseline up to follow-up 6-weeks after EOST (approximately up to 12,5 weeks), 13. Plasma concentrations versus time of fosmanogepix (prodrug) and manogepix (active moiety). Time Frame: Day 3: 0, 3, 6, 9 and 24 hours post-dose; Day 7, 14, 21, 28, 35; EOST: 72 and 192 hours post-dose

Source: https://euclinicaltrials.eu/ctis-public/view/2022-500455-23-00